EU clinical trial 2024-517407-36-00: Extended LH administration (ELHA), a strategy to increase the pool of recruitable antral follicles: a multicentric randomized trial
Sponsor: Azienda Ospedaliero Universitaria Di Modena (Hospital/Clinic/Other health care facility). Phase: Therapeutic exploratory (Phase II). Countries: Italy (ongoing, recruiting).
Therapeutic area(s): Diseases [C] - Female Urogenital Diseases and Pregnancy Complications [C13]
Gender: Female. Age: 18-64 years. Enrolment: 84.
Status: Ongoing, recruiting. Start date (EU): 2024-11-12. Decision date: 2024-11-25. Results received: No. Last updated: 2025-09-12.

Condition(s): Patients admitted to an IVF/ICSI cycle will be included. The patient will be addresses to the IVF cycles for the following reasons: tubal factor, male factor or for idiopathic infertility.
Product: Luveris 75 IU powder and solvent for solution for injection, Luveris 75 IU powder and solvent for solution for injection

Primary endpoint: The primary endpoint of the study will be to confirm that the pre-treatment with rhLH at the dose of 187.5 IU/day for 60 days may improve ovarian reserve as indicated by an increase in basal AMH.
Endpoint(s): • Change of AFC after 30/60 days • Change of AMH after 30 days • Ovarian response • Evaluate the safety of rLH • cycles discontinued/cancelled before rhCG administration • percent of missed transfer of fresh embryos • implantation rate • biochemical pregnancy rate • clinical pregnancy rate • early and late OHSS rate • miscarriage rate • preterm birth rate • low birth weight rate • congenital anomalies rate • gestational age at delivery • mean neonatal weight

Source: https://euclinicaltrials.eu/ctis-public/view/2024-517407-36-00